EU clinical trial 2023-504338-24-00: A PHASE 3 RANDOMIZED, DOUBLE-BLIND, PLACEBO-CONTROLLED STUDY EVALUATING THE EFFICACY AND SAFETY OF DOSE-TITRATED PLS240 IN THE TREATMENT OF SECONDARY HYPERPARATHYROIDISM IN INDIVIDUALS WITH END STAGE KIDNEY DISEASE ON HEMODIALYSIS (PATH-1) WITH AN OPEN-LABEL EXTENSION
Protocol code: PP3002
Sponsor: Pathalys Pharma Inc. (Pharmaceutical company). Phase: Therapeutic confirmatory (Phase III). Countries: Poland (ended), Portugal (ended), Spain (ended), Bulgaria (ended).
Therapeutic area(s): Diseases [C] - Male Urogenital Diseases [C12]; Diseases [C] - Female Urogenital Diseases and Pregnancy Complications [C13]; Diseases [C] - Hormonal diseases [C19]
Gender: Female, Male. Age: 18-64 years, 65+ years. Enrolment: 120.
Status: Ended. Start date (EU): 2023-11-09. End date (EU): 2025-06-26. End date: 2025-07-28. Decision date: 2023-09-25. Results received: No. Last updated: 2025-06-16.
Decision dates by country: ES: 2023-09-25, BG: 2023-10-02, PT: 2023-09-26, PL: 2023-10-02

Condition(s): ESKD participants with history of secondary hyperparathyroidism (SHPT) undergoing maintenance hemodialysis
Product: PLS240, PLS240, PLS240, PLS240, Excipients without the active substance, PLS240, PLS240, PLS240

Primary endpoint: The proportion of participants with a ≥30% decrease in mean iPTH during the Efficacy Assessment Period (EAP, Weeks 22 - 27) relative to the mean baseline iPTH (all Active Screening and predose Day 1 iPTH values)., Open-Label Phase • Safety clinical laboratory tests, vital signs, ECG, AEs, and physical exams ", Open-Label Phase • Proportion of participants with a cCa <7.5 mg/dL, and the proportion of participants with a cCa <8.3 mg/dL
Endpoint(s): • The proportion of participants with a ≥50% decrease in mean iPTH during the EAP (Weeks 22 - 27) relative to the mean baseline iPTH (all Active Screening and predose Day 1 iPTH values)., The proportion of participants with a mean iPTH during the EAP (Weeks 22 - 27) ≥150 pg/mL but ≤300 pg/mL., The percentage change from baseline in iPTH during the course of the study (weekly iPTH values)., The absolute and percentage changes in serum cCa and serum P levels and their mathematical product, •The proportion of participants who did not have an increase in Active Vitamin D sterol dose during the double blind phasewith a ≥30% reductionin mean iPTH during the EAP relative to mean baseline iPTH, Cmax and AUC as data permit., Removal rate by dialysis., Safety clinical laboratory tests, ECGs, vital signs, AEs, AEs leading to modification of dose or frequency of calcium supplements or phosphate binders, and physical exams, Proportion of participants with a cCa <7.5 mg/dL, and proportion of participants with a cCa <8.3 mg/dL

Source: https://euclinicaltrials.eu/ctis-public/view/2023-504338-24-00